EU clinical trial 2024-518835-13-00: A Prospective, Multi-National, Randomized, Double-Blind, Crossover Study to Evaluate the Efficacy and Safety of Gadopiclenol-enhanced MRA Compared to Gadoterate Meglumine-enhanced MRA in the Assessment of Steno-occlusive Disease in Adult Patients with Suspected Vascular Disease
Protocol code: GDX-102/GDX-44-017
Sponsor: Guerbet, Bracco Imaging S.p.A. (Pharmaceutical company). Phase: Therapeutic confirmatory (Phase III). Countries: Italy (ongoing, recruiting), France (ongoing, recruiting), Czechia (authorised, recruitment pending), Hungary (ongoing, recruiting), Spain (authorised, recruiting), Germany (authorised, recruitment pending), Poland (authorised, recruitment pending).
Therapeutic area(s): Diseases [C] - Cardiovascular Diseases [C14]
Gender: Female, Male. Age: 18-64 years, 65+ years. Enrolment: 300.
Start date (EU): 2026-05-19. Decision date: 2026-04-15. Results received: No. Last updated: 2026-08-07.
Decision dates by country: HU: 2026-04-20, IT: 2026-04-17, CZ: 2026-04-15, FR: 2026-04-17, DE: 2026-04-20, ES: 2026-04-20, PL: 2026-04-20

Condition(s): Suspected Vascular Disease of supra-aortic (carotid/vertebrobasilar), peripheral or abdominal/renal arteries
Product: DOTAREM 0,5 mmol/mL, solution injectable, GADOPICLENOL

Primary endpoint: Diagnostic performance indicators, namely sensitivity and specificity for detecting clinically significant steno-occlusive disease of different vascular territories.

Source: https://euclinicaltrials.eu/ctis-public/view/2024-518835-13-00